EU clinical trial 2024-515744-23-00: A trial in patients with blood cancer and lymphatic system cancer looking at finding the optimal dose of BMF-219
Protocol code: COVALENT-101
Sponsor: Biomea Fusion Inc. (Pharmaceutical company). Phase: Human Pharmacology (Phase I)- First administration to humans. Countries: Spain (ended), Netherlands (ended).
Therapeutic area(s): Diseases [C] - Neoplasms [C04]
Gender: Female, Male. Age: 18-64 years, 65+ years. Enrolment: 30.
Status: Ended. Start date (EU): 2023-02-15. End date (EU): 2025-03-05. End date: 2025-03-06. Decision date: 2024-10-08. Results received: No. Last updated: 2024-10-15.
Decision dates by country: ES: 2024-10-08, NL: 2024-10-15

Condition(s): Relapsed or refractory (R/R) Acute lymphoblastic leukemia (ALL), R/R Acute myeloid leukemia (AML), R/R Acute mixed-phenotype leukemia (AMPL), R/R Diffuse large B-cell lymphoma (DLBCL), R/R Chronic lymphocytic leukemia (CLL), R/R Small lymphocytic lymphoma (SLL)

Source: https://euclinicaltrials.eu/ctis-public/view/2024-515744-23-00